EU clinical trial 2023-507097-41-01: A Randomized, Double-Blind, Placebo-Controlled, Multi-Regional Phase III Clinical Study of Toripalimab Alone or in Combination With Tifcemalimab (JS004/TAB004) as Consolidation Therapy in Patients With Limited-Stage Small Cell Lung Cancer Without Disease Progression Following Chemoradiotherapy
Protocol code: JS004-008-III-SCLC
Sponsor: Shanghai Junshi Biosciences Co. Ltd. (Pharmaceutical company). Phase: Therapeutic confirmatory (Phase III). Countries: Italy (ended), Romania (ended), Germany (temporarily halted), Belgium (ended), Poland (ongoing, recruitment ended), France (not authorised), Spain (ongoing, recruiting), Netherlands (ongoing, recruiting).
Therapeutic area(s): Diseases [C] - Neoplasms [C04]
Gender: Female, Male. Age: 18-64 years, 65+ years. Enrolment: 147.
Start date (EU): 2025-03-20. Decision date: 2025-02-10. Results received: No. Last updated: 2026-07-16.
Decision dates by country: FR: 2025-02-12, IT: 2025-02-11, BE: 2025-02-10, RO: 2025-02-12, PL: 2025-02-11, DE: 2025-02-11, NL: 2025-02-11, ES: 2025-02-10

Condition(s): Patients with limited-stage small cell lung cancer (LS-SCLC) without disease progression after chemoradiotherapy (CRT)
Product: Toripalimab, TAB004, Tifcemalimab Placebo 5 mL/vial, Toripalimab Placebo 6 mL/vial

Primary endpoint: OS, BIRC-assessed PFS (per Response Evaluation Criteria in Solid Tumors (RECIST) v1.1).
Endpoint(s): Investigator-assessed PFS, 1-year and 2-year OS rates, - Investigator-assessed ORR - Investigator-assessed DCR. - Investigator-assessed DoR., - Safety: incidence of AEs, abnormal laboratory parameters. - PK of tifcemalimab and toripalimab: trough concentrations. - Immunogenicity of tifcemalimab and of toripalimab: incidence and titers of anti-drug antibodies (ADAs) and, if ADA positive, neutralizing antibodies (NAbs).

Source: https://euclinicaltrials.eu/ctis-public/view/2023-507097-41-01